EU clinical trial 2023-506357-38-00: A Phase I/II, Single-Arm, Open label Study to Evaluate the Pharmacokinetics, Safety/Tolerability and Efficacy of the Selumetinib Granule Formulation in Children Aged ≥ 1 to < 7 Years with Neurofibromatosis Type 1 (NF1) Related Symptomatic, Inoperable Plexiform Neurofibromas (PN) (SPRINKLE).
Protocol code: SPRINKLE D1346C00004
Sponsor: Astrazeneca AB (Pharmaceutical company). Phase: Phase I and Phase II (Integrated)- Other. Countries: Germany (ongoing, recruitment ended), Spain (ongoing, recruitment ended), Italy (ongoing, recruitment ended).
Therapeutic area(s): Diseases [C] - Nervous System Diseases [C10]
Gender: Female, Male. Age: 0-17 years. Enrolment: 26.
Status: Ongoing, recruitment ended. Start date (EU): 2022-02-17. Decision date: 2024-05-10. Results received: No. Last updated: 2026-07-20.
Decision dates by country: DE: 2024-05-13, IT: 2024-05-16, ES: 2024-05-10

Condition(s): Neurofibromatosis Type 1 (NF1) Related Plexiform Neurofibromas (PN)
Product: SELUMETINIB, Selumetinib, SELUMETINIB, Selumetinib

Primary endpoint: Selumetinib AUC0-12 derived after single dose administration. Safety and tolerability will be evaluated in terms of AEs, clinical safety laboratory assessments, physical examination, weight, vital signs, ECG, ECHO, ophthalmologic assessment, MRI/X-ray, and performance status. Assessments related to AEs will include: occurrence/frequency; relationship to study intervention; CTCAE grade; seriousness; death; AEs leading to discontinuation of study intervention; AEs of special interest.
Endpoint(s): Parent-reported observer palatability assessment. Plasma concentrations and PK parameters of selumetinib including: AUC0-6, AUC0-12, AUC0-24, Cmax, Rac Cmax, Rac AUC0-12, Vss/F, Vz/F, t½λz, AUClast, CL/F, tmax and tlast. Plasma concentrations and PK parameters of N desmethyl selumetinib including: Cmax, AUC0-6, AUC0-12, AUClast, tmax, tlast, Rac Cmax and Rac AUC0-12. Parent-to-metabolite ratio for AUC0-6, AUC0-12 and AUC0-24 and Cmax. Objective Response Rate (ORR). See CSP for more details.

Source: https://euclinicaltrials.eu/ctis-public/view/2023-506357-38-00